EU clinical trial 2025-521419-37-00: A study in healthy people to compare how 2 different formulations of survodutide are taken up in the body
Protocol code: 1404-0099
Sponsor: Boehringer Ingelheim International GmbH (Pharmaceutical company). Phase: Human Pharmacology (Phase I)- Other. Countries: Germany (ended).
Therapeutic area(s): Not possible to specify
Gender: Female, Male. Age: 18-64 years. Enrolment: 16.
Status: Ended. Start date (EU): 2025-07-22. End date (EU): 2025-10-28. Decision date: 2025-07-03. Results received: No. Last updated: 2025-07-03.

Condition(s): Healthy volunteer trial

Source: https://euclinicaltrials.eu/ctis-public/view/2025-521419-37-00